EU clinical trial 2023-505549-18-00: A Phase II, Double-blind, Placebo-controlled, Randomized, Dose-ranging, Parallel Group Study to Evaluate the Safety and Efficacy of PHA-022121 Administered Orally for Prophylaxis Against Angioedema Attacks in Patients with Hereditary Angioedema due to C1-Inhibitor Deficiency (Type I or Type II)
Protocol code: PHA022121-C301
Sponsor: Pharvaris Netherlands B.V. (Pharmaceutical company). Phase: Therapeutic exploratory (Phase II). Countries: Poland (ended), Austria (ended), Italy (ended), Ireland (ended), Bulgaria (ended), Germany (ended).
Therapeutic area(s): Phenomena and Processes [G] - Immune system processes [G12]
Gender: Female, Male. Age: 18-64 years, 65+ years. Enrolment: 21.
Status: Ended. Start date (EU): 2022-04-29. End date (EU): 2025-06-30. End date: 2025-07-01. Decision date: 2024-03-19. Results received: Yes. Last updated: 2025-01-15.
Decision dates by country: IT: 2024-03-21, PL: 2024-03-20, IE: 2024-03-19, AT: 2024-03-19, DE: 2024-03-19, BG: 2024-03-22

Condition(s): Hereditary angioedema due to C1-Inhibitor Deficiency (Type I or Type II)
Product: PHA-022121, Placebo for PHA-022121

Primary endpoint: Part-1 The primary efficacy endpoint will be the number of investigatorconfirmed HAE attacks during the treatment period in Part-1 (Day 0 through Day 84) and will be expressed as the normalized number of attacks per month (4 weeks) of exposure.
Endpoint(s): The secondary efficacy endpoints in Part-1 of the study are listed below. • Number of investigator-confirmed moderate or severe HAE attacks during the treatment period in Part 1 (Day 0 to Day 84). • Number of investigator-confirmed HAE attacks requiring acute treatment during the treatment period in Part 1. • Number of patients achieving ≥50% reduction in attack rate relative to baseline during the treatment period in Part 1., • Number of patients achieving ≥70% reduction in attack rate relative to baseline during the treatment period in Part 1. • Number of patients achieving ≥90% reduction in attack rate relative to baseline during the treatment period in Part 1. • Number of patients that are attack-free during the treatment period in Part 1. • Number and proportion of days with angioedema symptoms during the treatment period in Part 1., • Time to first investigator-confirmed HAE attack in the treatment period in Part 1.• Number of investigator-confirmed HAE attacks resulting in a visit to the emergency department or an admission to hospital during the treatment period in Part 1. The analyses of these secondary efficacy endpoints are considered supportive, all statistical tests comparing treatments are descriptive in nature and will be made without adjustment for multiplicity., Part 2 The efficacy endpoints in Part 2 of the study are:• Number of investigator-confirmed angioedema attacks during the treatment period in Part 2 (from time of the first open-label dose to the last dose, excluding the treatment gap in Part 2). • Number of investigator-confirmed moderate or severe angioedema attacks during the treatment period in Part 2., • Number of investigator-confirmed angioedema attacks requiring acute treatment during the treatment period in Part 2. • Incidence of HAE attacks during the treatment period in Part 2 (attackrate trend over time). • Number and proportion of days with angioedema symptoms during the treatment period in Part 2., The analysis of the efficacy endpoints in Part 2 will be performed based on the ITT analysis set. The number of investigator-confirmed HAE attacks during the treatment period in Part 2 will be expressed as the normalized number of attacks per month (4 weeks) of exposure. The normalized number of investigator-confirmed HAE attacks during the treatment period in Part 2 will be descriptively summarized., Similarly, normalized number of investigator-confirmed moderate or severe HAE attacks during the treatment period in Part 2, normalized number of investigator-confirmed HAE attacks requiring acute treatment during the treatment period in Part 2, and proportion of days with HAE symptoms during the treatment period in Part 2 will be summarized. All efficacy analyses in Part 2 will be descriptive.

Source: https://euclinicaltrials.eu/ctis-public/view/2023-505549-18-00